EU clinical trial 2025-522194-11-00: Pregnancy and Infant PrEparedness pLatform IN Europe (PIPELINE)-RSV immunisation adaptive platform trial
Sponsor: Fondazione Penta Ets (Patient organisation/association). Phase: Therapeutic confirmatory (Phase III). Countries: Belgium (authorised, recruitment pending), Netherlands (ongoing, recruiting).
Therapeutic area(s): Diseases [C] - Respiratory Tract Diseases [C08]
Gender: Female, Male. Age: In utero, 0-17 years, 18-64 years. Enrolment: 400.
Start date (EU): 2026-07-15. Decision date: 2025-11-04. Results received: No. Last updated: 2026-06-26.
Decision dates by country: NL: 2025-11-04, BE: 2025-11-04

Condition(s): Respiratory Syncytial Virus (RSV)
Product: Abrysvo powder and solvent for solution for injection Respiratory syncytial virus vaccine (bivalent, recombinant), Beyfortus 100 mg solution for injection in pre-filled syringe, Beyfortus 50 mg solution for injection in pre-filled syringe

Primary endpoint: Symptomatic RSV respiratory tract infection (RTI) in an infant, confirmed by an approved positive RSV test, by 12 months of age.

Source: https://euclinicaltrials.eu/ctis-public/view/2025-522194-11-00